EU clinical trial 2025-521316-19-00: Optimization of pain management for acute renal colic in the Emergency Department – The OPTIMIZED trial
Sponsor: Leids Universitair Medisch Centrum (LUMC) (Hospital/Clinic/Other health care facility). Phase: Therapeutic use (Phase IV). Countries: Netherlands (ongoing, recruiting).
Therapeutic area(s): Analytical, Diagnostic and Therapeutic Techniques and Equipment [E] - Anesthesia and Analgesia [E03]
Gender: Female, Male. Age: 18-64 years, 65+ years. Enrolment: 160.
Status: Ongoing, recruiting. Start date (EU): 2026-04-20. Decision date: 2025-11-21. Results received: No. Last updated: 2025-12-17.

Condition(s): Urolithiasis
Product: ROPIVACAINE, SODIUM CHLORIDE

Primary endpoint: To decrease pain intensity and pain interference, as measured with the Brief Pain Inventory Short Fort (BPI-SF). This is defined as the difference in scores 24 hours after the intervention between the two groups., To minimize hospitalizations and urologic interventions. This is defined as the difference in proportion of patients that required a same-day hospital admission or underwent a urologic intervention within seven days (yes/no).
Endpoint(s): A decrease in pain intensity as measured with the Numeric Rating Scale (NRS) be-tween baseline and 30 minutes, 60 minutes, six hours, twelve hours and 24 hours after the intervention (but only measured during the time the patient is awake)., Representations to the ED related to renal colic within seven days after the inter-vention, compared between both groups., Incidence of chronic pain, measured by the BPI-SF one month after the interven-tion. The definition of chronic secondary pain this study uses is “Pain that persists or recurs beyond successful treatment of the initial cause, Improvement of quality of life, measured by the EQ-5D-5L seven days and one month after the intervention, compared to baseline in both groups., Patient satisfaction, measured by Patient Global Impression of Change (PGIC) after 24 hours and seven days, compared between both groups, Reduction of use of analgesic rescue medication within the first 24 hours after the intervention, compared between both groups., Time to first analgesic rescue medication (both NSAIDs and opioids) after the inter-vention, compared between both groups., Reduction of opioid-related adverse events, measured by the Overall Benefit of Analgesia Score after 24 hours., Safety, measured as the number and type of serious adverse events (such as infection, bleeding, LAST or pneumothorax) related to the ESPB occurring within one month of the intervention., Cost-effectiveness: relating the costs of healthcare use and productivity losses related to the renal colic, measures via shortened versions of the iMTA Medical Consumption Ques-tionnaire (iMCQ) and iMTA Productivity Cost Questionnaire (iPCQ), up to one month after intervention to the quality of life

Source: https://euclinicaltrials.eu/ctis-public/view/2025-521316-19-00